EU clinical trial 2023-509076-42-00: Neoadjuvant Tebentafusp in Patients with Metastatic Uveal Melanoma
Protocol code: GEM 2302
Sponsor: Grupo Espanol Multidisciplinar De Melanoma (Patient organisation/association). Phase: Therapeutic exploratory (Phase II). Countries: Spain (ongoing, recruiting), Germany (authorised, recruiting).
Therapeutic area(s): Diseases [C] - Neoplasms [C04]
Gender: Female, Male. Age: 18-64 years, 65+ years. Enrolment: 19.
Start date (EU): 2025-07-18. Decision date: 2025-06-18. Results received: No. Last updated: 2026-03-16.
Decision dates by country: DE: 2025-06-18, ES: 2025-06-26

Condition(s): Metastatic uveal melanoma with resectable liver metastasis and absence of extra-liver disease
Product: KIMMTRAK 100 micrograms/0.5 mL concentrate for solution for infusion

Primary endpoint: The primary endpoint for NEO-TB trial is the pathological complete response (pCR) rate, defined as no presence of residual disease assessed by biopsy or surgical resection at 7 months (+/- 1 month) after the start of the scheduled tratment with tebentafusp. Patients with CR according to RECIST after 6 months who do not enter surgery phase and continue treatment with tebentafusp will be considered as achieving pCR as well.
Endpoint(s): Secondary efficacy endpoints: ● Objecitve response rate (ORR) according to RECIST 1.1 ● Disease control rate (DCR) according to RECIST 1.1 ● Relapse-free survival (RFS) according to RECIST 1.1 ● Event-free survival (EFS) ● Overall survival (OS), Secondary safety endpoints: ● Adverse events (AE) ● Treatment-related AEs (TRAEs), Exploratory endpoints:●Molecular biomarkers determined from liver biopsies at baseline and fresh samples from liver resections in lesions with viable tumors and samples of peripheral blood, Exploratory endpoints: ●Central assessment of TCR populations and peripheral lymphocytes memory cells in blood samples before/after tebentafusp and in the prospective fresh samples from liver resections, Exploratory endpoints: ●Correlation between ctDNA levels and presence of CTCs in blood samples at several time points and clinical efficacy and safety outcomes

Source: https://euclinicaltrials.eu/ctis-public/view/2023-509076-42-00